EU clinical trial 2024-516123-13-00: Tiratricol treatment of children with Monocarboxylate Transporter 8 deficiency: Triac Trial II (MCT8-2019-2)
Protocol code: MCT8-2019-2
Sponsor: Rare Thyroid Therapeutics International AB (Pharmaceutical company). Phase: Therapeutic exploratory (Phase II). Countries: Czechia (ongoing, recruitment ended), Netherlands (ongoing, recruitment ended).
Therapeutic area(s): Diseases [C] - Hormonal diseases [C19]
Gender: Male. Age: 0-17 years. Enrolment: 13.
Status: Ongoing, recruitment ended. Start date (EU): 2021-02-03. Decision date: 2024-08-26. Results received: No. Last updated: 2026-06-26.
Decision dates by country: NL: 2024-08-26, CZ: 2024-08-30

Condition(s): Monocarboxylate Transporter 8 (MCT8) deficiency
Product: Tiratricol, Tiratricol

Primary endpoint: Part I of the study: GMFM-88 total score and BSID-III Gross Motor Skill Domain at week 96 compared to natural history scores from the Triac Trial I study Part II of the study: GMFM-88 total score and BSID-III Gross Motor Skill Domain at 3 years and 4 years respectively, compared to natural history scores from the Triac Trial I study.
Endpoint(s): Part I and II:GMFM-88 individual item score 10 ("lifts head upright") and item score 24 ("sit on mat") at week 96, at 3 and 4 years respectively, compared to baseline; GMFM Domain B (Sitting) - summary score of all items 18-37 at week 96, at 3 and 4 years respectively, compared to baseline; Motor milestone responder analysis of Section 2 of the Hammersmith Infant Neurological Examination (HINE) at week 96, at 3 and 4 years respectively.

Source: https://euclinicaltrials.eu/ctis-public/view/2024-516123-13-00